EU clinical trial 2024-515372-12-00: Immune responses to influenza vaccinations and viruses among health care personnel
Sponsor: Finnish Institute For Health And Welfare (Laboratory/Research/Testing facility). Phase: Therapeutic use (Phase IV). Countries: Finland (ended).
Therapeutic area(s): Diseases [C] - Virus Diseases [C02]; Diseases [C] - Respiratory Tract Diseases [C08]
Gender: Female, Male. Age: 18-64 years. Enrolment: 1500.
Status: Ended. End date (EU): 2025-08-27. Decision date: 2024-08-27. Results received: No. Last updated: 2024-09-20.

Condition(s): Influenza, Immunity against influenza
Product: INFLUENZA, INACTIVATED, SPLIT VIRUS OR SURFACE ANTIGEN

Primary endpoint: Humoral immunity to influenza virus strains included in the vaccines of the current and past seasons as well as circulating influenza strains will be assessed from the serum samples with traditional hemagglutination inhibition (HI). Microneutralization or neutralization test (NT) may also be used.
Endpoint(s): Cellular immunity will be assessed from thawed PBMC samples after stimulation with circulating influenza virus and vaccine antigens in cell culture., Cytokine (IFN-gamma and others) responses will be assessed e.g. by measuring the concentration of secreted cytokines in the cell culture media with Luminex technology., mRNA expression of cytokines and other factors (e.g. inflammatory mediators and transcription factors) can be measured from specific cell populations enriched with magnetic cell separation or sorted with FACSAria flow cytometer.

Source: https://euclinicaltrials.eu/ctis-public/view/2024-515372-12-00